EU clinical trial 2024-517796-21-00: The Jason Study: Sulodexide (VESSEL®) for the prevention of recurrent venous thromboembolism in elderly patients after a first episode of venous thrombembolism
Sponsor: Fondazione Arianna Anticoagulazione (Patient organisation/association). Phase: Therapeutic confirmatory (Phase III). Countries: Italy (authorised, recruitment pending).
Therapeutic area(s): Diseases [C] - Cardiovascular Diseases [C14]
Gender: Female, Male. Age: 65+ years. Enrolment: 1455.
Status: Authorised, recruitment pending. Decision date: 2024-11-12. Results received: No. Last updated: 2024-12-09.

Condition(s): Prevention of recurrence after a first episode of Venous Thromboembolism (VTE)
Product: The placebo product consists of a soft capsule similar to the ones containing the active substance, VESSEL® 250 ULS capsule molli

Primary endpoint: Primary efficacy endpoint: -cumulative result of: new episodes of venous thromboembolism (proximal DVT and / or PE), overall mortality due to VTE, Primary safety endpoint: - incidence of major bleeding (MB), International Society on Thrombosis and Haemostasis [ISTH] criteria
Endpoint(s): Secondary efficacy endpoint: Superficial venin thrombosis; Isolated distal deep vein thrombosis;, Cardiovascular events that involved hospitalization; Death from cardiovascular events (myocardial infarction, ischemic stroke)., Secondary safety endpoint: Cumulative incidence of MB and non-major but clinically relevant haemorrhages [NMCRB]

Source: https://euclinicaltrials.eu/ctis-public/view/2024-517796-21-00